EU clinical trial 2024-519737-30-00: Weight-loss Effects aNd absorption of Direct oral anticoagulants in roux-en-Y gastric bypass patients: a prospective study (WENDY)
Sponsor: Amsterdam UMC Stichting (Patient organisation/association). Phase: Therapeutic use (Phase IV). Countries: Netherlands (authorised, recruitment pending).
Therapeutic area(s): Analytical, Diagnostic and Therapeutic Techniques and Equipment [E] - Diagnosis [E01]; Diseases [C] - Nutritional and Metabolic Diseases [C18]; Diseases [C] - Cardiovascular Diseases [C14]
Gender: Female, Male. Age: 18-64 years, 65+ years. Enrolment: 30.
Status: Authorised, recruitment pending. Decision date: 2025-05-26. Results received: No. Last updated: 2025-05-28.

Condition(s): Roux-en-Y gastric bypass
Product: Beriplex® P/N 250 I.E. Pulver und Lösungsmittel zur Herstellung einer Injektionslösung, NORIT 200 mg capsules., Ondexxya 200 mg powder for solution for infusion, APIXABAN

Primary endpoint: Area under the curve (AUC) of anti-Xa levels comparing at multiple timepoints: baseline (prior to surgery), +/-17 days untill 60days after surgery, +/-3 months after surgery
Endpoint(s): Measured weight and BMI at follow-up visit +3 months in relation to AUC anti-Xa difference, Frequence of major bleeding events as defined per ISTH criteria, and incidence of VTE, including pulmonary embolism and deep vein thrombosis

Source: https://euclinicaltrials.eu/ctis-public/view/2024-519737-30-00